EU clinical trial 2025-524713-88-00: Open-Label Extension Study to Provide Continued Access to Avutometinib Alone or in Combination with Defactinib in Patients with Recurrent Low-Grade Serous Ovarian Cancer (LGSOC)
Protocol code: VS-6766-206
Sponsor: Verastem Inc. (Pharmaceutical company). Phase: Therapeutic exploratory (Phase II). Countries: France (ongoing, recruiting).
Therapeutic area(s): Diseases [C] - Neoplasms [C04]
Gender: Female. Age: 18-64 years, 65+ years. Enrolment: 4.
Status: Ongoing, recruiting. Start date (EU): 2026-07-29. Decision date: 2026-06-22. Results received: No. Last updated: 2026-06-22.

Condition(s): Recurrent Low-Grade Serous Ovarian Cancer (LGSOC)
Product: VS-6063, VS-6766

Primary endpoint: Investigator’s determination of ongoing clinical benefit
Endpoint(s): Frequency and severity of side effects, including abnormal findings from laboratory tests or physical examinations

Source: https://euclinicaltrials.eu/ctis-public/view/2025-524713-88-00